EU clinical trial 2024-514776-40-00: Phase I-II trial of sunitinib and/or nivolumab plus chemotherapy in advanced soft tissue and bone sarcomas
Protocol code: GEIS-52
Sponsor: Asoc Grupo Espanol De Investigacion En Sarcomas (Patient organisation/association). Phase: Phase I and Phase II (Integrated)- Other. Countries: Spain (ongoing, recruitment ended), Italy (ended).
Therapeutic area(s): Diseases [C] - Neoplasms [C04]
Gender: Female, Male. Age: 0-17 years, 18-64 years, 65+ years. Enrolment: 185.
Start date (EU): 2017-03-23. Decision date: 2025-01-13. Results received: No. Last updated: 2026-06-04.
Decision dates by country: IT: 2025-01-28, ES: 2025-01-13

Condition(s): Advanced soft tissue and bone sarcomas
Product: Sutent 12.5 mg hard capsules, Sutent 25 mg hard capsules, OPDIVO 10 mg/mL concentrate for solution for infusion.

Primary endpoint: Stage 1. Phase 1. The recommended dose of the sunitinib and nivolumab combination for phase II part will be determined by assessing adverse events according to CTCAE 4.0 and they will be used as a rule for escalating or diminishing dose levels according to the dose-limiting toxicities detailed in the protocol., Stage 1. Phase 2. Progression-free survival rate (PFSR): Efficacy measured by the PFSR at 6 months according to RECIST 1.1. PFSR at 6 months is defined as the percentage of patients who did not experience progression or death due to any cause since enrollment until month 6 after enrollment., Stage 2. Cohorts 1-6. Phase 2. 1. CS/DDCS, EMC, VS, SFT, and CCS cohorts: 6-month progression-free survival rate (PFSR): Efficacy measured by the PFSR at 6 months according to RECIST 1.1. PFSR at 6 months is defined as the percentage of patients who did not experience progression or death due to any cause since enrollment until month 6 after enrollment., Stage 2. Cohorts 1-6. Phase 2. 2. ASPS cohort: 12-month progression-free survival rate (PFSR): Efficacy measured by the PFSR at 12 months according to RECIST 1.1. PFSR at 12 months is defined as the percentage of patients who did not experience progression or death due to any cause since the date of enrollment until month 12 after enrollment., Stage 2. Cohort 7. Phase 1b. The maximum tolerated dose (MTD) of the epirubicin + ifosfamide + nivolumab combination will be determined by assessing adverse events according to CTCAE 5.0 and they will be used for adjusting dose levels according to the dose-limiting toxicities detailed in the protocol., Stage 2. Cohort 8. Phase 1. The maximum tolerated dose (MTD) of the MAP + nivolumab combination will be determined by assessing adverse events according to CTCAE 5.0 and they will be used for adjusting dose levels according to the dose-limiting toxicities detailed in the protocol., Stage 2. Cohort 8. Phase 2. Proportion of patients achieving good pathological response (≥90% necrosis) in the surgical specimen after neoadjuvant chemotherapy + nivolumab.
Endpoint(s): Stage 1. Phase 1. 1. Safety profile of the experimental treatment, through assessment of adverse event type, incidence, severity, time of appearance, related causes, as well as physical explorations and laboratory tests. Toxicity will be graded and tabulated by using CTCAE 4.0., Stage 1. Phase 1. 2. Progression-free survival rate (PFSR): Efficacy measured by the PFSR at 6 months according to RECIST 1.1. PFSR at 6 months is defined as the percentage of patients who did not experience progression or death due to any cause since enrollment until month 6 after enrollment., Stage 1. Phase 1. 3. Overall survival (OS): OS is defined as the time between the date of enrollment and the date of death due to any cause. OS will be censored on the last date a subject was known to be alive., Stage 1. Phase 1. 4. Overall response rate (ORR): ORR is defined as the number of subjects with a best overall response (BOR) of complete response (CR) or partial response (PR) divided by the number of response evaluable subjects (according to RECIST 1.1 criteria)., Stage 1. Phase 1. 5. Contribution to translational studies will be performed by providing biological samples., Stage 1. Phase 2. 1. Overall survival (OS): OS is defined as the time between the date of enrollment and the date of death due to any cause. OS will be censored on the last date a subject was known to be alive., Stage 1. Phase 2. 2. Overall response rate (ORR): ORR is defined as the number of subjects with a best overall response (BOR) of complete response (CR) or partial response (PR) divided by the number of response evaluable subjects (according to RECIST 1.1 criteria)., Stage 1. Phase 2. 3. Efficacy measured through tumor response according to Choi criteria. The evaluation criteria will be based on the identification of target lesions in baseline and their follow up until tumor progression., Stage 1. Phase 2. 4. Safety profile of the experimental treatment, through assessment of adverse event type, incidence, severity, time of appearance, related causes, as well as physical explorations and laboratory tests. Toxicity will be graded and tabulated by using CTCAE 4.0., Stage 1. Phase 2. 5. Clinical outcomes of post protocol treatments assessed by observation of such treatments in follow-up stage., Stage 1. Phase 2. 6. Contribution to translational studies will be performed by providing biological samples., Stage 2. Cohorts 1-6. Fase 2. 1. Overall survival (OS): OS is defined as the time between the date of enrollment and the date of death due to any cause. OS will be censored on the last date a subject was known to be alive., Stage 2. Cohorts 1-6. Fase 2. 2. Overall response rate (ORR): ORR is defined as the number of subjects with a best overall response (BOR) of complete response (CR) or partial response (PR) divided by the number of response evaluable subjects (according to RECIST 1.1 criteria)., Stage 2. Cohorts 1-6. Fase 2. 3. Safety profile of the experimental treatment, through assessment of adverse event type, incidence, severity, time of appearance, related causes, as well as physical explorations and laboratory tests. Toxicity will be graded and tabulated by using CTCAE 5.0., Stage 2. Cohorts 1-6. Fase 2. 4. Clinical outcomes of post protocol treatments assessed by observation of such treatments in follow-up stage., Stage 2. Cohorts 1-6. Fase 2. 5. Correlation between efficacy and potential predictive biomarkers assessed by finding relationships between clinical efficacy results and translational data., Stage 2. Cohorts 1-6. Fase 2. 6. Prognostic and response correlation with neutrophils/platelets; lymphocytes/platelets; and red blood cell distribution width (RDW), by assessing hematology tests at baseline, after 2 weeks (before nivolumab), after 1 month, at progression, and at response., Stage 2. Cohorts 1-6. Fase 2. 7. 6-month progression-free survival rate (PFSR): Efficacy measured by the PFSR at 6 months according to RECIST 1.1. PFSR at 6 months is defined as the percentage of patients who did not experience progression or death due to any cause since the date of enrollment until month 6 after enrollment., Stage 2. Cohort 7. Phase 1b. 1. Safety profile of the experimental treatment, through assessment of adverse event type, incidence, severity, time of appearance, related causes, as well as physical explorations and laboratory tests. Toxicity will be graded and tabulated by using CTCAE 5.0., Stage 2. Cohort 7. Phase 1b. 2. Overall response rate (ORR): ORR is defined as the number of subjects with a best overall response (BOR) of complete response (CR) or partial response (PR) divided by the number of response evaluable subjects (according to RECIST 1.1 criteria and central review)., Stage 2. Cohort 7. Phase 1b. 3. Median progression-free survival (mPFS): PFS is defined as the time between the date of enrollment and the date of progression or death due to any cause., Stage 2. Cohort 7. Phase 1b. 4. Median overall survival (mOS): OS is defined as the time between the date of enrollment and the date of death due to any cause. OS will be censored on the last date a subject was known to be alive., Stage 2. Cohort 8. Phase 1. 1. Safety profile of the experimental treatment, through assessment of adverse event type, incidence, severity, time of appearance, related causes, as well as physical explorations and laboratory tests. Toxicity will be graded and tabulated by using CTCAE 5.0., Stage 2. Cohort 8. Phase 1. 2. Pathological response measured by percentage of necrosis in surgical specimen., Stage 2. Cohort 8. Phase 1. 3. Overall response rate (ORR): ORR is defined as the number of subjects with a best overall response (BOR) of complete response (CR) or partial response (PR) divided by the number of response evaluable subjects (according to RECIST 1.1 criteria and central review)., Stage 2. Cohort 8. Phase 2. 1. Safety profile of the experimental treatment, through assessment of adverse event type, incidence, severity, time of appearance, related causes, as well as physical explorations and laboratory tests. Toxicity will be graded and tabulated by using CTCAE 5.0., Stage 2. Cohort 8. Phase 2. 2. Overall response rate (ORR): ORR is defined as the number of subjects with a best overall response (BOR) of complete response (CR) or partial response (PR) divided by the number of response evaluable subjects (according to RECIST 1.1 criteria and central review)., Stage 2. Cohort 8. Phase 2. 3. 12-month progression-free survival rate (PFSR): Efficacy measured by the PFSR at 12 months after surgery according to RECIST 1.1. PFSR at 12 months is defined as the percentage of patients who did not experience progression or death due to any cause since the date of surgery until month 12 after surgery., Stage 2. Cohort 8. Phase 2. 4. Median progression-free survival (mPFS): PFS is defined as the time between the date of enrollment and the date of progression or death due to any cause., Stage 2. Cohort 8. Phase 2. 5. Median overall survival (mOS): OS is defined as the time between the date of enrollment and the date of death due to any cause. OS will be censored on the last date a subject was known to be alive.

Source: https://euclinicaltrials.eu/ctis-public/view/2024-514776-40-00